EU clinical trial 2023-506193-12-00: EORTC 1634-BTG (NOA-23): Personalized Risk-Adapted Therapy in Post-Pubertal Patients with Newly Diagnosed Medulloblastoma (PersoMed-I)
Protocol code: 1634
Sponsor: European Organisation For Research And Treatment Of Cancer (Patient organisation/association). Phase: Therapeutic exploratory (Phase II). Countries: Germany (ended).
Therapeutic area(s): Diseases [C] - Neoplasms [C04]
Gender: Female, Male. Age: 0-17 years, 18-64 years, 65+ years. Enrolment: 32.
Status: Ended. Start date (EU): 2022-11-10. End date (EU): 2025-09-10. End date: 2025-12-15. Decision date: 2024-07-02. Results received: Yes. Last updated: 2025-03-28.

Condition(s): Newly Diagnosed Medulloblastoma
Product: LOMUSTINE, Odomzo 200 mg hard capsules, VINCRISTINE, CISPLATIN

Primary endpoint: Progression-Free Survival (PFS) according to RAPNO assessed by central reviewer of a personalized intensity-modulated therapy (experimental arm; sonidegib) compared to standard therapy in SHH-activated patients in post-pubertal patients with newly diagnosed standard risk medulloblastoma.
Endpoint(s): Progression-Free Survival (PFS) by central reviewer in WNT and Group 3 & Group 4 subgroups, Progression-Free Survival (PFS) by local investigator, Overall survival (OS), Frequencies and percentages of worst adverse events (AEs) or laboratory event; grades according to CTCAE v.5 (with neurological, kidney, auditory, endocrine and radiotherapy associated as AE of special interest), Patient reported outcomes: • Health-related Quality of life (HRQol): EORTC QLQ-C30 and BN20, social functioning as scale of special interest • Survivorship outcomes (five items from EORTC QLQ-SURV111) • Neurocognitive function (NCF): Hopkins Verbal Learning Test, Controlled Oral Word Association Trail Making Test Part A, Trail Making Test Part B, cerebellar cognitive affective/Schmahmann syndrome scale.

Source: https://euclinicaltrials.eu/ctis-public/view/2023-506193-12-00